EU clinical trial 2023-506539-14-00: A Phase 1 Study Evaluating the Safety, Tolerability, and Efficacy of BL-B01D1 in Subjects with Metastatic or Unresectable Non-Small Cell Lung Cancer and Other Solid Tumors
Protocol code: BL-B01D1-LUNG-101
Sponsor: Systimmune Inc. (Pharmaceutical company). Phase: Human Pharmacology (Phase I)- Other. Countries: France (ongoing, recruiting), Spain (ongoing, recruiting), Italy (ongoing, recruiting).
Therapeutic area(s): Diseases [C] - Neoplasms [C04]; Diseases [C] - Respiratory Tract Diseases [C08]
Gender: Female, Male. Age: 18-64 years, 65+ years. Enrolment: 95.
Status: Ongoing, recruiting. Start date (EU): 2025-05-27. Decision date: 2024-05-20. Results received: No. Last updated: 2026-04-01.
Decision dates by country: ES: 2024-05-20, IT: 2024-05-22, FR: 2024-05-27

Condition(s): Oncology

Source: https://euclinicaltrials.eu/ctis-public/view/2023-506539-14-00